EU clinical trial 2023-503371-25-00: Does the Glucagon-like Peptide 1 (GLP-1) receptor agonist semaglutide reduce alcohol intake in patients with Alcohol Use Disorder and comorbid obesity?
Sponsor: Region Hovedstaden (Hospital/Clinic/Other health care facility). Phase: Therapeutic exploratory (Phase II). Countries: Denmark (ended).
Therapeutic area(s): Psychiatry and Psychology [F] - Mental Disorders [F03]
Gender: Female, Male. Age: 18-64 years, 65+ years. Enrolment: 108.
Status: Ended. Start date (EU): 2023-06-08. End date (EU): 2025-09-08. Decision date: 2023-05-12. Results received: Yes. Last updated: 2025-07-08.

Condition(s): Alcohol Use Disorder
Product: Wegovy 2.4 mg FlexTouch solution for injection in pre-filled pen, SALINE

Primary endpoint: Change in alcohol consumption, defined as the change in percentage of heavy drinking days during a period of 30 consecutive days* , after 26 weeks of treatment adjusted for baseline (percentage points (pp)). The 30-day period will be the 30 consecutive days with the biggest alcohol intake (most heavy drinking days and the largest amount of total alcohol intake) out of the 40 days prior to the evaluation, measured by the TLFB method
Endpoint(s): Change in total alcohol consumption (gram/last 30 consecutive days), Change in number of days without alcohol consumption (last 30 consecutive days), Change in drinks per day (last 30 consecutive days), Time to relapse, defined as the time to first alcohol intake, Time to first heavy drinking day, Reduction in WHO alcohol risk level (last 30 consecutive days), Change in Penn Alcohol Craving Scale (PACS) score, Change in Alcohol Use Disorder Identification Test (AUDIT) score, Change in Drug Use Disorders Identification Test (DUDIT) score, Change in Fibrosis-4 (FIB4) score, Change in measures of health (WHOQOL-BREF-score), Change in Fagerströms Test for Nicotine Dependence score, Change in blood gamma-glutamyl transferase (GGT), Change in blood alanine transaminase (ALAT), Change in plasma levels of phosphatidyl ethanol (PEth), Change in blood mean cell volume (MCV), Change in body weight, Change in blood pressure, Change in pulse, Change in waist circumference, Change in glycaemic control parameters (HbA1c), Change in brain GABA levels (cortical, caudate, and putamen) assessed by MRS brain scans, Change in brain alcohol cue-response in reward-processing brain regions (ventral and dorsal striatum, putamen, nucleus accumbens, and caudate), including the septal area assessed by fMRI brain scans, Change in heavy drinking days during a period of 30 consecutive days measured by the TLFB, after 26 weeks of treatment adjusted for baseline (percentage points (pp)) and maximum tolerable semaglutide dose given., Change in heavy drinking days during a period of 30 consecutive days measured by the TLFB, after 26 weeks of treatment adjusted for baseline (percentage points (pp)) and weight loss during the 26 weeks of treatment.

Source: https://euclinicaltrials.eu/ctis-public/view/2023-503371-25-00